EU clinical trial 2023-504900-28-00: A Phase 1/2 Clinical Study of Intravenous Gene Transfer with an AAVrh10 Vector Expressing GALC in Krabbe Subjects Receiving Hematopoietic Stem Cell Transplantation (RESKUE)
Protocol code: FBX-101-RESKUE
Sponsor: Forge Biologics Inc. (Pharmaceutical company). Phase: Phase I and Phase II (Integrated)- First administration to humans. Countries: Spain (not authorised).
Therapeutic area(s): Diseases [C] - Nervous System Diseases [C10]
Gender: Female, Male. Age: 0-17 years. Enrolment: 2.
Status: Not authorised. Decision date: 2023-08-04. Results received: No. Last updated: 2023-08-04.

Condition(s): Krabbe Disease
Product: FBX-101

Primary endpoint: Incidence and severity of adverse events and serious adverse events that are attributed to FBX-101, HSCT incident of engraftment
Endpoint(s): Improvement of probability to achieve independent sitting compared to untreated patients or those receiving HSCT only at one year and two years post gene therapy, Improvement of gross motor function, as measured by Peabody Developmental Motor Scale 2nd Edition (PDMS-2), above a functional age equivalent of 12 months, compared to untreated patients or those receiving HSCT only, at 2 years post gene therapy

Source: https://euclinicaltrials.eu/ctis-public/view/2023-504900-28-00